EU clinical trial 2023-508112-35-00: A phase II study assessing safety and efficacy of REPotrectinib in ROS1-positive non-small cell lung cancer patients with active brain mEtastasis (The REPOSE study)
Protocol code: MEDOPP662
Sponsor: Medica Scientia Innovation Research S.L., Medical University Of Vienna (Pharmaceutical company, Educational Institution). Phase: Therapeutic exploratory (Phase II). Countries: Germany (authorised, recruiting), Spain (ongoing, recruiting), Austria (ongoing, recruiting).
Therapeutic area(s): Diseases [C] - Neoplasms [C04]
Gender: Female, Male. Age: 18-64 years, 65+ years. Enrolment: 20.
Start date (EU): 2025-04-15. Decision date: 2024-11-12. Results received: No. Last updated: 2025-12-12.
Decision dates by country: ES: 2024-11-14, DE: 2024-11-12, AT: 2024-11-18

Condition(s): ROS1-positive non-small cell lung cancer (NSCLC) with active brain metastasis
Product: Repotrectinib (TPX-0005)

Primary endpoint: IC-ORR at any timepoint as judged by best central nervous system (CNS) response according to the Response assessment in neuro-oncology brain metastases (RANO-BM) criteria.
Endpoint(s): PFS, defined as the period from treatment initiation to the first occurrence of disease progression or death from any cause, whichever occurs first, as determined locally by the investigator using RECIST v.1.1., OS, defined as the period from treatment initiation to death from any cause, as determined locally by the investigator., EC-ORR, defined as the rate of patients with complete response (CR) or partial response (PR), as determined locally by the investigator using RECIST v.1.1., CBR, defined as the rate of patients with objective response (CR or PR), or stable disease for at least 24 weeks, as determined locally by the investigator using RECIST v.1.1., DCR, defined as the percentage of patients with advanced cancer whose therapeutic intervention has led to a complete response, partial response, or stable disease., TTR, defined as the period from treatment initiation to the first objective tumor response (tumor shrinkage of ≥ 30%) observed for patients who achieved a CR or PR, as determined locally by the investigator using RECIST v.1.1., DoR, defined as the period from the first occurrence of a documented objective response to disease progression or death from any cause, whichever occurs first, as determined locally by the investigator using RECIST v.1.1., Best percentage of change in tumor burden (RANOBM) for intracranial lesions 3 and RECIST v.1.1 for extracranial and overall lesions (bicompartmental ORR)., Safety endpoints: Changes from baseline in the EORTC QLQ-C30 and EORTC QLQ-BN20 scales, and symptoms scores., Safety endpoints: Neurological function assessment as per NANO scale., Safety endpoints: Safety and tolerability as per NCI-CTCAE v.5.0., Exploratory endpoints: Exploratory endpoints can include (but are not limited to): Relationship of treatment efficacy outcomes in all patients with biomarkers analyzed in blood samples., Exploratory endpoints Exploratory endpoints can include (but are not limited to): Association of efficacy outcomes in all patients with radiological imaging biomarkers., Exploratory endpoints Exploratory endpoints can include (but are not limited to): Efficacy endpoints for all patients according to ROS1 gene expression level at baseline.

Source: https://euclinicaltrials.eu/ctis-public/view/2023-508112-35-00